EU clinical trial 2024-513610-34-00: Pembrolizumab and trastuzumab in combination with FLOT in the perioperative treatment of HER2-positive, localized esophagogastric adenocarcinoma - A phase II trial of the AIO study group – PHERFLOT
Protocol code: PHERFLOT
Sponsor: Frankfurter Institut Fuer Klinische Krebsforschung IKF GmbH (Pharmaceutical company). Phase: Therapeutic exploratory (Phase II). Countries: Germany (ended).
Therapeutic area(s): Diseases [C] - Neoplasms [C04]; Diseases [C] - Digestive System Diseases [C06]
Gender: Female, Male. Age: 18-64 years, 65+ years. Enrolment: 30.
Status: Ended. Start date (EU): 2023-02-13. End date (EU): 2026-08-05. Decision date: 2024-10-11. Results received: No. Last updated: 2025-06-30.

Condition(s): HER2-positive, localized esophagogastric adenocarcinoma
Product: Ontruzant 420 mg powder for concentrate for solution for infusion, Oxaliplatin onkovis 5 mg/ml Konzentrat zur Herstellung einer Infusionslösung, KEYTRUDA 25 mg/mL concentrate for solution for infusion, TAXOTERE 20 mg/1 ml concentrate for solution for infusion, Oncofolic 50 mg/ml, Injektions-/Infusionslösung, 5-FU medac 50 mg/ml, Injektionslösung

Primary endpoint: disease-free survival and the pathological complete response rate (co-primary)
Endpoint(s): ORR – percentage of patients with CR or partial response (PR) according to RECIST 1.1., R0 resection - microscopically margin negative resection with no gross or microscopic tumor remains in the areas of the primary tumor and/or sampled regional lymph nodes., OS – time from enrolment to the date of death of any cause Feasibility rate - severe toxicity/withdrawal rate before the last postoperative administration of pembrolizumab/trastuzumab/FLOT has been completed., (Serious) adverse events - recorded and graded according to NCI-CTCAE V5.0. Occurrence of (serious) adverse events at any time during the study. Description by nature (System Organ Class and Preferred Term), severity and causal relationship to drug administration.

Source: https://euclinicaltrials.eu/ctis-public/view/2024-513610-34-00